EU clinical trial 2024-515001-26-00: PROPHYLACTIC ANTIBIOTIC TREATMENT IN END-STAGE KIDNEY DISEASE AND CENTRAL VENOUS CATHETER AS HEMODIALYSIS VASCULAR ACCESS
Protocol code: 12020
Sponsor: Region Sjaelland (Hospital/Clinic/Other health care facility). Phase: Therapeutic use (Phase IV). Countries: Denmark (ongoing, recruiting).
Therapeutic area(s): Diseases [C] - Bacterial Infections and Mycoses [C01]
Gender: Female, Male. Age: 18-64 years, 65+ years. Enrolment: 800.
Status: Ongoing, recruiting. Start date (EU): 2024-07-25. Decision date: 2024-07-25. Results received: No. Last updated: 2024-07-25.

Condition(s): Blood poisoning in patients with renal failure treated with hemodialysis
Product: Clindamycin ”Alternova”, hårde kapsler, Amoxicillin/clavulansyre ”Aurobindo”, filmovertrukne tabletter

Primary endpoint: Hospitalization for BSI ≤ 6 months after randomization, Hospitalization ≥ 3 days due to infection defined as: CRP ≥ 75 and negative blood cultures, treated with iv antibiotics, and occurring ≤ 6 months after randomization

Source: https://euclinicaltrials.eu/ctis-public/view/2024-515001-26-00